EU clinical trial 2022-500571-32-00: INDIE: Phase II Trial of Individualized Immunotherapy in Early-Stage Unfavorable Classical Hodgkin Lymphoma
Protocol code: Uni-Koeln-4470
Sponsor: University Of Cologne (Educational Institution). Phase: Therapeutic exploratory (Phase II). Countries: Germany (ongoing, recruitment ended).
Therapeutic area(s): Diseases [C] - Neoplasms [C04]
Gender: Female, Male. Age: 18-64 years, 65+ years. Enrolment: 120.
Status: Ongoing, recruitment ended. Start date (EU): 2024-05-15. Decision date: 2023-12-18. Results received: No. Last updated: 2026-05-04.

Condition(s): Early-Stage Unfavorable Classical Hodgkin Lymphoma
Product: VINBLASTINE, DACARBAZINE, DOXORUBICIN, Tislelizumab

Primary endpoint: 1-year progression-free survival (PFS) estimate
Endpoint(s): Adverse events, 3-year PFS estimate, 1- and 3-year overall survival (OS) estimates, Patient-reported outcomes (PRO-CTCAE, quality of life), Remission status after 2 doses of tislelizumab as determined by PET-2 (DS) and MTV-2, respectively, Remission status after completion of (chemo-) immunotherapy as determined by PET-6 (DS) and MTV-6, respectively, Remission status after end of treatment, Types of treatment applied in addition to trial treatment

Source: https://euclinicaltrials.eu/ctis-public/view/2022-500571-32-00